EU clinical trial 2023-506867-33-01: A prospective, multi-centre study (B-Sure) to evaluate long-term durability of treatment response in chronic hepatitis B participants with and without nucleos(t)ide therapy who have participated in a previous bepirovirsen treatment study.
Protocol code: 206882
Sponsor: Glaxosmithkline Research & Development Limited (Pharmaceutical company). Phase: Therapeutic exploratory (Phase II). Countries: Italy (ongoing, recruitment ended), Romania (ongoing, recruitment ended), Poland (ongoing, recruitment ended), Bulgaria (ongoing, recruitment ended), Greece (ongoing, recruitment ended), Hungary (ongoing, recruitment ended), Spain (ongoing, recruitment ended), France (ongoing, recruitment ended), Germany (ongoing, recruitment ended).
Therapeutic area(s): Diseases [C] - Virus Diseases [C02]
Gender: Female, Male. Age: 18-64 years, 65+ years. Enrolment: 108.
Status: Ongoing, recruitment ended. Start date (EU): 2022-01-25. Decision date: 2024-02-28. Results received: No. Last updated: 2026-04-23.
Decision dates by country: BG: 2024-05-20, RO: 2024-03-04, IT: 2024-03-11, GR: 2024-05-23, HU: 2024-02-28, FR: 2025-05-21, DE: 2025-03-10, PL: 2024-04-10, ES: 2024-02-28

Condition(s): Chronic Hepatitis B

Primary endpoint: For 209668 (B-Clear; not-on-NA): Time from achieving FC, to first occurrence of either HBsAg or HBV DNA reversion, or first use of any rescue medication., For 209668 (B-Clear; on-NA), 209348 (BTogether; on-NA), 212602 (B-Fine; on-NA), 202009 and 219288 (B-Well 1 & 2; on-NA)and 217023 (TH HBV ASO-001; on-NA): Time from achieving FC (24 weeks post NA cessation) to first occurrence of either HBsAg or HBV DNA reversion, or first use of any rescue medication, For 202009 and 219288 (B-Well 1 & 2; NAcessated): Time from achieving FC (including delayed FC) in the parent study to first occurrence of either HBsAg or HBV DNA reversion, or first use of any rescue medication.
Endpoint(s): For 209668 (B-Clear; on-NA), 209348 (BTogether; on-NA), 212602 (B-Fine; on-NA),217023 (TH HBV ASO-001; on-NA) and 202009 and 219288 (B-Well 1 & 2; on-NA): • Time from NA cessation to the first occurrence of HBsAg reversion or first use of any rescue medication, For 209668 (B-Clear; on-NA), 209348 (BTogether; on-NA), 212602 (B-Fine; on-NA),217023 (TH HBV ASO-001; on-NA) and 202009 and 219288 (B-Well 1 & 2; on-NA): Time from NA cessation to the first occurrence of virologic relapse or first use of any rescue medication, For 209668 (B-Clear; on-NA), 209348 (BTogether; on-NA), 212602 (B-Fine; on-NA),217023 (TH HBV ASO-001; on-NA) and 202009 and 219288 (B-Well 1 & 2; on-NA): Time from NA cessation to the first occurrence of clinical relapse or first use of any rescue medication, For 209668 (B-Clear; on-NA), 209348 (BTogether; on-NA), 212602 (B-Fine; on-NA),217023 (TH HBV ASO-001; on-NA) and 202009 and 219288 (B-Well 1 & 2; on-NA): Time from NA cessation to the first use of rescue medication, For 202009 and 219288 (B-Well 1 & 2; NAcessated): Time from NA cessation to the first occurrence of HBsAg reversion or first use of any rescue medication. Time from NA cessation to the first occurrence of virologic relapse or first use of any rescue medication., For 202009 and 219288 (B-Well 1 & 2; NAcessated): Time from NA cessation to the first occurrence of clinical relapse or first use of any rescue medication. Time from NA cessation to first use of any rescue medication., For 209668 (B-Clear; on-NA), 209348 (BTogether; on-NA), 212602 (B-Fine; on-NA): • Time from achieving complete response in the previous bepirovirsen treatment study, to first occurrence of either HBsAg or HBV DNA reversion, or first use of any rescue medication, 202009 and 219288 (B-Well 1 & 2; On-NA) and 217023 (TH HBV ASO-001; on-NA): •Time from HBsAg and HBV DNA , to first occurrence of either HBsAg or HBV DNA reversion, or first use of any rescue medication., For 209668 (B-Clear; not-on-NA) partial responders: a. Time from end of treatment in the parent study to delayed FC. b. For participants who go on to achieve delayed FC: Time from achieving delayed FC to loss of FC., For 202009 and 219288 (B-Well 1 & 2; NA-cessated) partial responders: a. Time from NA cessation to delayed FC. b. For participants who go on to achieve delayed FC: Time from achieving delayed FC to loss of FC., For 209668 (B-Clear; on-NA), 209348 (BTogether; on-NA), 212602 (B-Fine; on-NA), 202009 and 219288 (B-Well 1&2; on-NA), and 217023 (TH HBV ASO-001; on-NA): a. Time from NA cessation in B-Sure to delayed FC in B-Sure. b. For participants who achieve delayed FC in B-Sure: Time from achieving delayed FC to loss of FC., For 209668 (B-Clear; on-NA), 209348 (BTogether; on-NA), 212602 (B-Fine; on-NA), 217023 (TH HBV ASO-001; on-NA) and 202009 and 219288 (B-Well 1&2; on-NA): a.Time from end of treatment in the parent study to delayed complete response. b. For participants who achieve a delayed complete response: Time from achieving delayed complete response to loss of response., For 209668 (B-Clear; on-NA), 209348 (BTogether; on-NA), 212602 (B-Fine; on-NA), 202009 and 219288 (B-Well 1 & 2; on-NA) and 217023 (TH HBV ASO-001; on-NA): Time from NA cessation to HBsAg loss in the absence of any rescue medication., For 209668 (B-Clear; on-NA), 209348 (BTogether; on-NA), 212602 (B-Fine; on-NA), 202009 and 219288 (B-Well 1 & 2; on-NA) and 217023 (TH HBV ASO-001; on-NA): Time from NA cessation to the first occurrence of virologic relapse or first use of any rescue medication., For 209668 (B-Clear; on-NA), 209348 (BTogether; on-NA), 212602 (B-Fine; on-NA), 202009 and 219288 (B-Well 1 & 2; on-NA) and 217023 (TH HBV ASO-001; on-NA): Time from NA cessation to the first occurrence of clinical relapse or first use of any rescue medication, For 209668 (B-Clear; on-NA), 209348 (BTogether; on-NA), 212602 (B-Fine; on-NA), 202009 and 219288 (B-Well 1 & 2; on-NA) and 217023 (TH HBV ASO-001; on-NA): Time from NA cessation to the first use of rescue medication.

Source: https://euclinicaltrials.eu/ctis-public/view/2023-506867-33-01